EU clinical trial 2023-506370-13-00: Involvement of the serotonergic system in the control of impulsivity in Tourette disorder : ARITEP
Protocol code: 69HCL22_0683
Sponsor: Hospices Civils De Lyon (Hospital/Clinic/Other health care facility). Phase: Therapeutic exploratory (Phase II). Countries: France (ongoing, recruiting).
Therapeutic area(s): Diseases [C] - Nervous System Diseases [C10]
Gender: Female, Male. Age: 18-64 years, 65+ years. Enrolment: 20.
Status: Ongoing, recruiting. Start date (EU): 2024-09-05. Decision date: 2023-10-24. Results received: No. Last updated: 2026-06-29.

Condition(s): Tourette disorder
Product: [18F]-Altanserin, ARIPIPRAZOLE

Primary endpoint: Correlation coefficients between changes in the binding potential (BPND) of [18F]-altanserin measured voxel-by-voxel in the whole brain and the evolution of scores BIS11 in TD patients.
Endpoint(s): Correlation coefficients between changes in the binding potential (BPND) of [18F]-altanserin measured voxel-by-voxel in the whole brain and the evolution of other clinical scores and task performance of TD patients., Correlation coefficients between changes in the BOLD signal measured voxel-by-voxel in the whole brain and the evolution of scores BIS11 in TD patients., Correlation coefficients between changes in the BOLD signal measured voxel-by-voxel in the whole brain and the evolution of other clinical scores and task performance of TD patients.

Source: https://euclinicaltrials.eu/ctis-public/view/2023-506370-13-00